EU clinical trial 2024-513310-36-01: i-Care; Quantitative-imaging in cardiac transthyretin amyloidosis
Sponsor: Universitair Medisch Centrum Groningen (Hospital/Clinic/Other health care facility). Phase: Therapeutic use (Phase IV). Countries: Netherlands (authorised, recruitment pending).
Therapeutic area(s): Diseases [C] - Cardiovascular Diseases [C14]
Gender: Female, Male. Age: 18-64 years, 65+ years. Enrolment: 64.
Status: Authorised, recruitment pending. Decision date: 2024-09-19. Results received: No. Last updated: 2024-09-19.

Condition(s): Transthyretin amyloid cardiomyopathy
Product: Radio-Flu 0,1 - 4 GBq/ml oplossing voor injectie, MIBG (I123) 74 MBq/mL oplossing voor injectie Jobenguaan (123I)

Primary endpoint: Quantification of myocardial microcalcification on 18F-sodiumfluoride PET/CT and quantification of cardiac autonomic function on [123I]MIBG imaging.
Endpoint(s): Change in myocardial microcalcification activity and myocardial innervation on 18F-sodiumfluoride PET/CT and [123I]-MIBG respectively, Cardiac indices on magnetic resonance imaging, such as left ventricular ejection fraction, left ventricular mass, extracellular volume and global longitudinal strain, Cardiac biomarkers including NT-ProBNP and high-sensitivity cardiac troponin I, Clinical measures, such as 6MWT test, KCCQ-OS and Norfolk QOL‐DN

Source: https://euclinicaltrials.eu/ctis-public/view/2024-513310-36-01